EU clinical trial 2024-517628-20-00: Optimal medical treatment of uncontrolled hypertension. OPTIMAL-HT
Protocol code: 2020/ABM/01/00037
Sponsor: Narodowy Instytut Kardiologii Stefana Kardynala Wyszynskiego Panstwowy Instytut Badawczy (Hospital/Clinic/Other health care facility). Phase: Phase III and phase IV (Integrated). Countries: Poland (ongoing, recruiting).
Therapeutic area(s): Diseases [C] - Cardiovascular Diseases [C14]
Gender: Female, Male. Age: 18-64 years, 65+ years. Enrolment: 1154.
Status: Ongoing, recruiting. Start date (EU): 2023-10-24. Decision date: 2024-12-16. Results received: No. Last updated: 2026-03-02.

Condition(s): hypertension, Overpressure
Product: Triplixam, 10 mg + 2,5 mg + 10 mg, tabletki powlekane, Ludipress Lactose monohydrate; Povidone K30; Crospovidone; Colloidal silicon dioxide; Magnesium stearate, Lactose monohydrate; Sodium lauryl sulfate Magnesium stearate, Toramide; 10 mg, tabletki, Colloidal silicon dioxide Ludipress; Lactose monohydrate; Povidone K30; Krospovidone Magnesium stearate, Espiro, 25 mg, tabletki powlekane, Spironol, 25 mg, tabletki, Elestar HCT, 40 mg + 5 mg + 12,5 mg, tabletki powlekane, Elestar HCT, 40 mg + 10 mg + 25 mg, tabletki powlekane, Triplixam, 5 mg + 1,25 mg + 5 mg, tabletki powlekane

Primary endpoint: • Phase A The variable quantifying the efficacy of current antihypertensive treatment will be the percentage of patients with uncontrolled BP (24h mean SBP values ≥ 125 mm Hg or 24h mean DBP values ≥ 80 mm Hg) in relation to the ITT-A size., • Phase B The efficacy of switching of the previous drug regimen to a triple SPC (as the efficacy of the treatment strategy) and of each of two triple SPC drugs (P+I+A group and O+H+A, as the efficacy of each triple SPC) will be measured as the percentages of patients who achieve BP control defined as 24h mean SBP values < 125 mm Hg and 24h mean DBP values < 80 mm Hg). These would be assessed at the Visit 5 after 12 weeks of treatment in the ITT-B data set., • Phase C The main analysis of the differences in the change from baseline (Visit 6) to week 12 (Visit 8) in mean 24h SBP measured on ABPM between the groups will be conducted on the PP set. ABPM measurements obtained after premature discontinuation of treatment will be excluded from this analysis (i.e., considered as missing, not included to PP set). The treatment groups of patients in this analysis are eplerenone group, torasemide group and spironolactone group.
Endpoint(s): Phase A: - Percentage of patients with BP controlled confirmed by HBPM (mean over the period of 6 days, SBP ≥130 mm Hg or DBP ≥80 mm Hg), Phase A: - Consistency of the rate of uncontrolled BP between ABPM and HBPM

Source: https://euclinicaltrials.eu/ctis-public/view/2024-517628-20-00